EU clinical trial 2025-524377-16-00: Multicentre, randomised, double-blind, placebo-controlled clinical trial to confirm the efficacy, safety, and clinical impact of the mucosal bacterial therapeutic vaccine MV140 in women with non-complicated recurrent urinary tract infections (rUTIs).
Protocol code: MV140-SLG-074
Sponsor: Inmunotek S.L. (Pharmaceutical company). Phase: Therapeutic confirmatory (Phase III). Countries: Portugal (authorised, recruitment pending).
Therapeutic area(s): Diseases [C] - Bacterial Infections and Mycoses [C01]
Gender: Female. Age: 18-64 years, 65+ years. Enrolment: 252.
Status: Authorised, recruitment pending. Decision date: 2026-05-19. Results received: No. Last updated: 2026-08-06.

Condition(s): Recurrent Non-Complicated Urinary Tract Infections (rUTIs).
Product: Placebo for MV140, NITROFURANTOIN, FOSFOMYCIN, PIVMECILLINAM

Primary endpoint: Number of new episodes of UTIs (confirmed both by the presence of symptoms (dysuria, overactive bladder, frequent and sudden urge to urinate), pelvic pain (pressure pain), pollakiuria, turbid white urine, haematuria, foul-smelling urine, polyuria, urinary itching, urgency of urination, etc) and a positive urine culture during 15 months after the beginning of the trial intervention in both arms, and percentage of patients who show new UTI episodes in this period.
Endpoint(s): Proportion of participants with less than 3 new UTIs during 15 months after the beginning of the trial intervention in both arms., Time in days from the first IMP administration to a new episode of UTI after first IMP administration in both arms., Time in days from the last IMP administration to a new episode of UTI after IMP treatment completion in both arms., Duration of each new UTI episode in days after the beginning of the trial intervention in both arms., Assessment of the severity score of the UTI episode, as determined by the Visual Analogue Score (VAS) score of each new UTI episode, after beginning of the trial intervention in both arms. This assessment will be performed during unscheduled visits in case a new episode of rUTIs is suspected., Number (and percentage of patients in each arm) of subjects who have not shown a new episode of UTI during 15 months after the beginning of the trial intervention in both arms., Number of cycles of systemic antibiotic treatments used for UTI episodes during 15 months after the beginning of the trial intervention in both arms., Descriptive analysis of use of health resources: o To compare number of hospital admissions between two arms o To compare number of emergency hospital visits between two arms o To compare number of outpatients services or visits due to a rUTI between two arms., Descriptive analysis of assessment of the pain by the visual analogue scale (VAS) throughout the entire study in both arms., Quality of life assessment according to the SF-36 questionnaire in both arms., Adverse events (AEs), serious adverse events (SAEs), AR, SAR and SUSAR (number of events and number of participants) occurring during the entire clinical trial, with their severity and relationship to the trial intervention, and also changes in vital signs and laboratory values during the clinical trial in both arms.

Source: https://euclinicaltrials.eu/ctis-public/view/2025-524377-16-00